EU clinical trial 2024-513111-27-00: A Multi-Center, Randomized, Double-Blind, Placebo- and Active-Controlled Phase 3 Study to Evaluate the Efficacy and Safety of Zasocitinib (TAK-279) in Subjects With Active Psoriatic Arthritis Who Are Naïve to Biologic Disease-Modifying Antirheumatic Drugs (LATITUDE-PsA-3001)
Protocol code: TAK-279-PsA-3001
Sponsor: Takeda Development Center Americas Inc. (Pharmaceutical company). Phase: Therapeutic confirmatory (Phase III). Countries: Germany (ongoing, recruiting), Latvia (ongoing, recruiting), Hungary (ongoing, recruiting), Estonia (ongoing, recruiting), Belgium (ongoing, recruiting), Poland (ongoing, recruiting), Bulgaria (ongoing, recruiting), Czechia (ongoing, recruiting), Spain (ongoing, recruiting), Croatia (ongoing, recruiting), Italy (ongoing, recruiting), Portugal (ongoing, recruiting).
Therapeutic area(s): Diseases [C] - Musculoskeletal Diseases [C05]
Gender: Female, Male. Age: 18-64 years, 65+ years. Enrolment: 708.
Status: Ongoing, recruiting. Start date (EU): 2025-06-26. Decision date: 2025-05-05. Results received: No. Last updated: 2026-07-09.
Decision dates by country: LV: 2025-05-09, BG: 2025-06-06, IT: 2025-06-09, BE: 2025-05-12, DE: 2025-05-06, HR: 2025-06-09, PL: 2025-05-13, PT: 2025-06-05, HU: 2025-05-06, EE: 2025-05-08, CZ: 2025-06-04, ES: 2025-06-04

Condition(s): Psoriatic Arthritis
Product: Otezla 10mg, 20mg, 30 mg film-coated tablets, Otezla 10mg, 20mg, 30 mg film-coated tablets, Otezla 10mg, 20mg, 30 mg film-coated tablets, Matching Placebo for TAK-279 Dose A, Matching Placebo for Apremilast, ZASOCITINIB, ZASOCITINIB, Matching Placebo for TAK-279 Dose B

Primary endpoint: ACR20 response: Assessed as proportion of subjects achieving ACR20 at Week 16.
Endpoint(s): 1. Key Secondary endpoint : Zasocitinib Dose A vs. Placebo • MDA: Assessed as proportion of subjects achieving MDA status at Week 16. • PASI75 response (in subjects with a baseline ≥3% BSA): Assessed as proportion of subjects achieving ≥75% improvement from baseline in PASI score at Week 16., 2. Key Secondary endpoint: ACR50 response: Assessed as proportion of subjects achieving ACR50 at Week 16. • Change from baseline in the HAQ-DI score at Week 16. • ACR70 response: Assessed as proportion of subjects achieving ACR70 at Week 16., 3. Key Secondary endpoint: Change from baseline in the SF-36 v2.0 PCS score at Week 16. • Change from baseline in the FACIT-Fatigue score at Week 16., 4. Key Secondary endpoint: Zasocitinib Dose B vs. Placebo • MDA: Assessed as proportion of subjects achieving MDA status at Week 16. • ACR50 response: Assessed as proportion of subjects achieving ACR50 at Week 16., 5. Key Secondary endpoint: Change from baseline in the HAQ-DI score at Week 16. • ACR70 response: Assessed as proportion of subjects achieving ACR70 at Week 16., 6. Key Secondary endpoint: PASI75 response (in subjects with a baseline ≥3% BSA): Assessed as proportion of subjects achieving ≥75% improvement from baseline in PASI score at Week 16., 7. Key Secondary endpoint: Zasocitinib Dose A vs. active comparator • ACR20 response: Assessed as proportion of subjects achieving ACR20 at Week 16. • PASI75 response (in subjects with a baseline ≥3% BSA): Assessed as proportion of subjects achieving ≥75% improvement from baseline in PASI score at Week 16., 8. Key Secondary endpoint: Zasocitinib Dose B vs. active comparator • ACR20 response: Assessed as proportion of subjects achieving ACR20 at Week 16., 1. Zasocitinib Dose A vs. Placebo Zasocitinib Dose B vs. Placebo • Enthesitis resolution in subjects with enthesitis at baseline (LEI >0): Assessed as proportion of subjects meeting LEI=0 at Week 16. • Change from baseline in individual components of ACR response at Week 16., 2. • Dactylitis resolution in subjects with dactylitis (LDI Basic >0) at baseline: Assessed as proportion of subjects meeting LDI Basic=0 at Week 16. • PASI75 response (in subjects with ≥3% BSA at baseline) at Week 4. • PASI75 response (in subjects with ≥3% BSA at baseline) at Week 8., 3. PASI90 response (in subjects with ≥3% BSA at baseline) at Week 16. • PASI100 response (in subjects with ≥3% BSA at baseline) at Week 16., 4. ACR50 and PASI100 response (in subjects with ≥3% BSA at baseline): Assessed as proportion of subjects simultaneously achieving ACR50 and PASI100 at Week 16., 5. sPGA 0/1 response (in subjects with baseline sPGA ≥2): Assessed as proportion of subjects achieving an sPGA of clear (0) or almost clear (1) with a ≥2-point decrease from baseline at Week 16., 6. HAQ-DI response: Assessed as proportion of HAQ-DI minimal clinically important differences responders (defined as achieving a clinically meaningful reduction of ≥0.35 from baseline) at Week 16. • Change from baseline in the SF-36 v2.0 MCS score at Week 16., 7. Change from baseline in PsAID-12 total score at Week 16. • Change from baseline in DAPSA score at Week 16., 8. Change from baseline in DAS28[CRP] score at Week 16. • Change from baseline in PGA-F score in subjects with psoriatic nail involvement (PGA-F>0) at baseline at Week 16., 9. Zasocitinib Dose B vs. Placebo • Change from baseline in the SF-36 v2.0 PCS score at Week 16. • Change from baseline in the FACIT-Fatigue score at Week 16., 10. Zasocitinib Dose A vs. active comparator Zasocitinib Dose B vs. active comparator • ACR50 response: Assessed as proportion of subjects achieving ACR50 at Week 16. • ACR70 response: Assessed as proportion of subjects achieving ACR70 at Week 16., 11. PASI90 response (in subjects with ≥3% BSA at baseline) at Week 16. • PASI100 response (in subjects with ≥3% BSA at baseline) at Week 16., 12. ACR50 and PASI100 response (in subjects with ≥3% BSA at baseline): Assessed as proportion of subjects simultaneously achieving ACR50 and PASI100 at Week 16. • MDA: Assessed as proportion of subjects achieving MDA status at Week 16., • Enthesitis resolution in subjects with enthesitis (SPARCC Enthesitis Index >0) at baseline: Assessed as proportion of subjects meeting SPARCC Enthesitis Index=0 through Week 16. • ACR20 response: Assessed as proportion of subjects achieving ACR20 at Week 8.

Source: https://euclinicaltrials.eu/ctis-public/view/2024-513111-27-00